EU clinical trial 2025-521008-22-00: Impact of time of alpelisib administration, concomitant fasting and low carbohydrate diet on alpelisib toxicity and efficacy; a pilot randomized controlled phase IIb trial- ITACA
Protocol code: CBYL719A0HR01T
Sponsor: Croatian Cooperative Group For Clinical Trial Research In Oncology (Patient organisation/association). Phase: Therapeutic exploratory (Phase II). Countries: Croatia (not authorised).
Therapeutic area(s): Diseases [C] - Neoplasms [C04]
Gender: Female, Male. Age: 18-64 years, 65+ years. Enrolment: 30.
Status: Not authorised. Decision date: 2025-02-27. Results received: No. Last updated: 2025-02-27.

Condition(s): metasatic breast cancer, hormon positive, her 2 negative
Product: Piqray 50 mg and 200 mg film-coated tablets

Primary endpoint: Exposure-adjusted incidence rate of grade 3 or 4 hyperglycemia within the first 3 months or 30 days after the treatment discontinuation whichever comes first
Endpoint(s): 1) Median time to the first grade 3 or 4 hyperglycemia from the first dose of study treatment until 30 days from permanent treatment discontinuation, 2) Exposure-adjusted incidence rate of any grade hyperglycemia within the first 3 months or 30 days after the treatment discontinuation whichever comes first 3) ORR from randomization to 30 days after the treatment discontinuation PFS from randomization to the end of the study 4) Exposure-adjusted incidence rate of all grade hyperglycemia,

Source: https://euclinicaltrials.eu/ctis-public/view/2025-521008-22-00